EU clinical trial 2022-502116-36-00: A Phase 3 Multicenter, Randomized, Double-blinded, Active-controlled, Clinical Study to Evaluate the Safety and Efficacy of Lenvatinib (E7080/MK-7902) with Pembrolizumab (MK-3475) in Combination with Transarterial Chemoembolization (TACE) Versus TACE in Participants with Incurable/Non-metastatic Hepatocellular Carcinoma (LEAP-012)
Protocol code: MK-7902-012
Sponsor: Merck Sharp & Dohme LLC (Pharmaceutical company). Phase: Therapeutic confirmatory (Phase III). Countries: Germany (ended), Portugal (ended), Italy (ended), Ireland (ended), Denmark (ended), Spain (ended), Hungary (ended), France (ended), Norway (ended).
Therapeutic area(s): Diseases [C] - Neoplasms [C04]
Gender: Female, Male. Age: 18-64 years, 65+ years. Enrolment: 200.
Status: Ended. Start date (EU): 2020-07-10. End date (EU): 2025-11-26. End date: 2026-03-23. Decision date: 2023-07-28. Results received: No. Last updated: 2025-08-26.
Decision dates by country: DK: 2023-07-28, HU: 2023-07-31, PT: 2023-07-31, IT: 2023-07-31, ES: 2023-07-28, NO: 2023-08-01, IE: 2023-07-28, DE: 2023-07-31, FR: 2023-08-09

Condition(s): Incurable/Non-metastatic Hepatocellular Carcinoma
Product: KEYTRUDA 25 mg/mL concentrate for solution for infusion, Lenvatinib, Placebo for Lenvatinib, Placebo for Keytruda, normal commercial saline

Primary endpoint: Progression-free Survival (PFS) per Response Evaluation Criteria in Solid Tumors Version 1.1 (RECIST 1.1), Overall Survival (OS)
Endpoint(s): PFS per Modified Response Evaluation Criteria in Solid Tumors (mRECIST), Objective Response Rate (ORR) per mRECIST, Disease Control Rate (DCR) per mRECIST, Duration of Response (DOR) per mRECIST, Time to Progression (TTP) per mRECIST, Percentage of Participants Who Experience At Least One Adverse Event (AE), Percentage of Participants Who Experience At Least One Serious Adverse Event (SAE), Percentage of Participants Who Experience At Least One Hepatic Event of Clinical Interest (ECI), Percentage of Participants Who Discontinue Study Drug Due to an AE, ORR per RECIST 1.1, DCR per RECIST 1.1, DOR per RECIST 1.1, TTP per RECIST 1.1

Source: https://euclinicaltrials.eu/ctis-public/view/2022-502116-36-00